EU clinical trial 2023-506722-36-00: A study to test how well multiple doses of BI 765423 are tolerated by healthy men
Protocol code: 1493-0008
Sponsor: Boehringer Ingelheim International GmbH (Pharmaceutical company). Phase: Human Pharmacology (Phase I)- Other. Countries: Belgium (ended).
Therapeutic area(s): Not possible to specify
Gender: Male. Age: 18-64 years. Enrolment: 60.
Status: Ended. Start date (EU): 2024-04-30. End date (EU): 2025-04-29. Decision date: 2024-02-26. Results received: No. Last updated: 2025-05-06.
Decision dates by country: BE: 2024-03-22

Condition(s): Healthy volunteer trial

Source: https://euclinicaltrials.eu/ctis-public/view/2023-506722-36-00